EU clinical trial 2024-513500-34-00: An open-label study to determine the long-term safety, tolerability and biological activity of SAR421869 in patients with Usher syndrome Type 1B
Protocol code: LTS13619
Sponsor: Sanofi-Aventis Recherche & Developpement (Pharmaceutical company). Phase: Therapeutic exploratory (Phase II). Countries: France (ongoing, recruitment ended).
Therapeutic area(s): Diseases [C] - Congenital, Hereditary, and Neonatal Diseases and Abnormalities [C16]
Gender: Female, Male. Age: 18-64 years. Enrolment: 4.
Status: Ongoing, recruitment ended. Start date (EU): 2015-11-09. Decision date: 2024-09-12. Results received: No. Last updated: 2026-04-01.

Condition(s): Usher's syndrome
Product: SAR421869

Primary endpoint: The incidence of adverse events
Endpoint(s): Clinically important changes in ocular safety assessments, Delay in retinal degeneration

Source: https://euclinicaltrials.eu/ctis-public/view/2024-513500-34-00